EU clinical trial 2023-509947-29-00: A phase II, open-label, multicenter study of orally administered RVU120 for the treatment of anemia in patients with lower-risk myelodysplastic neoplasms (MDS)
Protocol code: REMARK_001
Sponsor: GCP-Service International West GmbH (Pharmaceutical company). Phase: Therapeutic exploratory (Phase II). Countries: France (ended), Italy (ended), Germany (ended), Poland (ended), Spain (ended).
Therapeutic area(s): Diseases [C] - Neoplasms [C04]; Diseases [C] - Hemic and Lymphatic Diseases [C15]
Gender: Female, Male. Age: 18-64 years, 65+ years. Enrolment: 45.
Status: Ended. Start date (EU): 2024-07-18. End date (EU): 2026-05-26. Decision date: 2024-07-08. Results received: No. Last updated: 2026-06-08.
Decision dates by country: DE: 2024-07-08, FR: 2024-07-11, IT: 2024-07-09, PL: 2024-09-06, ES: 2024-07-12

Condition(s): Anemia in patients with very low, low or intermediate risk myelodysplastic neoplasms (MDS)
Product: SEL120 monohydrochloride, SEL120 monohydrochloride

Primary endpoint: The primary efficacy endpoint is erythroid response (HI-E) according to IWG 2018 criteria. Measured after 8 full cycles of RVU120 administration (dose of 150 mg). In determining the response rate, patients who do not complete the treatment or are not assessable for response after treatment count as failures (non-responders).
Endpoint(s): Safety Measurements: Toxicity as measured by NCI CTCAE v5.0, Efficacy Measurements: HI-E response duration - Measured from the time measurement criteria are met for HI-E (IWG 2018 HI criteria) until the first date at which loss of response is objectively documented., Efficacy Measurements: Time to HI-E - Defined as the time from first administration of RVU120 (C1D1) until the time measurement criteria are met for HI-E (IWG 2018 HI criteria)., Efficacy Measurements: Hemoglobin changes from baseline - Defined as changes in hemoglobin measurement from first administration of RVU120 (C1D1) until end of treatment visit (EOT)., Efficacy Measurements: Red blood cell transfusion (RBC) independence ≥ 8 and ≥ 12 weeks - Defined as lack of need for RBC transfusions until after 8 weeks of treatment and beyond and after 12 weeks of treatment and beyond., Efficacy Measurements: Frequency of RBC transfusions in transfusion dependent patients - Defined as the number of RBC units transfused from first RVU120 administration (C1D1) until end of treatment visit (EOT)., Efficacy Measurements: Neutrophil and platelet (HI-N and HI-P) responses - HI-N and HI-P according to IWG 2018 criteria. Measured from first RVU120 administration (C1D1)., Efficacy Measurements: Progressive disease (PD) according to IWG 2023 criteria. Defined by any of the following criteria: - Disease progression by blasts: ≥ 50% relative increase in blasts and absolute increase of blast percentage by at least 5% from pretreatment sample taken before current line of therapy, Efficacy Measurements: Progressive disease (PD) according to IWG 2023 criteria. Defined by any of the following criteria: - Disease progression by worsening cytopenia: new, repeated (more than once and separated by ≥ 7 days) need for RBC or platelet transfusions within 8 weeks, not related to acute intercurrent illness (eg, sepsis, gastrointestinal tract bleed) or treatment effect, in the absence of HI of at least one other blood lineage as defined above, Efficacy Measurements: Progressive disease (PD) according to IWG 2023 criteria. Defined by any of the following criteria: - Progression to AML: ≥ 50% increase in blasts from baseline assessment to ≥ 20% blasts., Efficacy Measurements: Complete remission (CR) according to IWG 2023 criteria (only patients with ≥ 5% myeloblasts at baseline). Defined as follows: - BM: < 5% myeloblasts, dysplasia may persist - PB: Hb ≥ 10 g/dL, platelets ≥100 × 10(9)/L; neutrophils ≥1.0 × 10(9)/L; blasts 0%, Efficacy Measurements: Partial remission (PR) according to IWG 2023 criteria (only patients with ≥ 5% myeloblasts at baseline). Defined as follows: - All CR criteria except: ▪ BM blasts decreased by ≥ 50% over pretreatment but still ≥ 5% ▪ Cellularity and morphology not relevant, Efficacy Measurements: Quality of life assessment - Scores of EORTC QLQ-C30 (version 3) ▪ Global health status / QoL ▪ Functional scales ▪ Symptom scales / items ▪ Assessment in paper form, Efficacy Measurements: Only for pEP type 2 responders and non-responders: • Erythroid response (HI-E) after 8 cycles of treatment at 250 mg dose according to IWG 2018 criteria

Source: https://euclinicaltrials.eu/ctis-public/view/2023-509947-29-00